EU clinical trial 2024-516911-26-00: A study investigating the safety, tolerability, metabolism, and elimination of INE963, a new compound in the treatment of malaria.
Protocol code: CINE963A02103
Sponsor: Novartis Pharma AG (Pharmaceutical company). Phase: Human Pharmacology (Phase I)- First administration to humans. Countries: Netherlands (ended).
Therapeutic area(s): Diseases [C] - Parasitic Diseases [C03]
Gender: Female, Male. Age: 18-64 years. Enrolment: 114.
Status: Ended. Start date (EU): 2025-05-07. End date (EU): 2026-07-04. End date: 2026-07-05. Decision date: 2025-04-09. Results received: No. Last updated: 2026-03-02.

Condition(s): Malaria

Source: https://euclinicaltrials.eu/ctis-public/view/2024-516911-26-00